EU clinical trial 2025-520582-51-00: An Open-label, Randomized, Phase 3 Study to Evaluate Patritumab Deruxtecan Monotherapy versus Treatment of Physician’s Choice in Hormone Receptor-positive, HER2-negative Unresectable Locally Advanced or Metastatic Breast Cancer (HERTHENA-Breast04)
Protocol code: MK-1022-016
Sponsor: Merck Sharp & Dohme LLC (Pharmaceutical company). Phase: Therapeutic confirmatory (Phase III). Countries: Greece (ongoing, recruiting), Poland (ongoing, recruitment ended), France (ongoing, recruiting), Italy (ongoing, recruiting), Spain (ongoing, recruiting), Hungary (ongoing, recruiting), Germany (ongoing, recruiting).
Therapeutic area(s): Diseases [C] - Neoplasms [C04]
Gender: Female, Male. Age: 18-64 years, 65+ years. Enrolment: 211.
Start date (EU): 2025-10-17. Decision date: 2025-09-29. Results received: No. Last updated: 2026-05-08.
Decision dates by country: DE: 2025-09-30, GR: 2025-10-03, PL: 2025-10-06, FR: 2025-11-13, ES: 2025-10-02, IT: 2025-10-02, HU: 2025-10-03

Condition(s): Hormone receptor positive breast cancer
Product: MK-1022, CAPECITABINE, PACLITAXEL, TRASTUZUMAB DERUXTECAN, PACLITAXEL ALBUMIN-BOUND, DOXORUBICIN, DOXORUBICIN HYDROCHLORIDE, LIPOSOMAL

Primary endpoint: Progression Free Survival (PFS), Overall Survival (OS)
Endpoint(s): Objective Response Rate (ORR), Duration of Response (DOR), Change from Baseline in European Organization for Research and Treatment of Cancer Quality of Life Questionnaire-Core 30 (EORTC QLQ-C30) Global Health Status-Quality of Life Score, Change from Baseline in EORTC QLQ-C30 Physical Functioning Score, Change from Baseline in EORTC QLQ-C30 Emotional Functioning Score, Change from Baseline in EORTC QLQ-C30 Pain Score, Time to First Deterioration (TTD) in EORTC QLQ-C30 Global Health Status-Quality of Life Score, TTD in EORTC QLQ-C30 Physical Functioning Score, TTD in EORTC QLQ-C30 Emotional Functioning Score, TTD in EORTC QLQ-C30 Pain Score, Number of Participants Who Experience an Adverse Event (AE), Number of Participants Who Discontinue Study Treatment Due to an AE

Source: https://euclinicaltrials.eu/ctis-public/view/2025-520582-51-00